EU clinical trial 2022-501476-25-00: J2T-MC-KGBI/DRM06-AD13: A Randomized, Double-Blind, Placebo-Controlled, Phase 3 Study to Assess the Efficacy, Safety and Pharmacokinetics of Lebrikizumab Compared to Placebo in Participants 6 Months to <18 Years of Age with Moderate-to-Severe Atopic Dermatitis
Sponsor: Eli Lilly & Co. (Pharmaceutical company). Phase: Therapeutic confirmatory (Phase III). Countries: Poland (ended), Spain (ended), Czechia (ended), Germany (ended), France (ended).
Therapeutic area(s): Diseases [C] - Skin and Connective Tissue Diseases [C17]
Gender: Female, Male. Age: 0-17 years. Enrolment: 89.
Status: Ended. Start date (EU): 2023-09-12. End date (EU): 2025-10-30. Decision date: 2023-07-04. Results received: No. Last updated: 2026-06-16.
Decision dates by country: FR: 2023-07-06, DE: 2023-07-04, PL: 2023-07-10, CZ: 2023-07-04, ES: 2023-07-10

Condition(s): Atopic Dermatitis; Eczema
Product: Placebo to match LY3650150, Lebrikizumab

Primary endpoint: Percentage of Participants with an Investigator Global Assessment (IGA) score 0 or 1 and a Reduction ≥2 points from Baseline, Percentage of Participants Achieving Eczema Area and Severity Index-75 (EASI-75) ≥75% Reduction from Baseline in EASI Score

Source: https://euclinicaltrials.eu/ctis-public/view/2022-501476-25-00